EU clinical trial 2024-512127-36-00: A Phase I/II, Open-Label, Multicenter Study to Assess the Safety, Tolerability, Pharmacokinetics and Anti-tumor Efficacy of DZD9008 in Patients with Advanced Non-Small Cell Lung Cancer (NSCLC) with EGFR or HER2 mutation
Protocol code: DZ2019E0001
Sponsor: Dizal Pharmaceutical Co. Ltd. (Pharmaceutical company). Phase: Phase I and Phase II (Integrated)- Other. Countries: Spain (ended), Italy (ended), France (ongoing, recruitment ended).
Therapeutic area(s): Diseases [C] - Neoplasms [C04]
Gender: Female, Male. Age: 18-64 years, 65+ years. Enrolment: 64.
Start date (EU): 2022-03-31. Decision date: 2024-07-08. Results received: No. Last updated: 2026-06-19.
Decision dates by country: ES: 2024-07-15, IT: 2024-07-15, FR: 2024-07-08

Condition(s): Non-Small Cell Lung Cancer
Product: Sunvozertinib, Sunvozertinib

Primary endpoint: In Part A, the primary endpoints for determining the MTD and RP2D are the incidence of dose-limiting toxicities (DLTs), adverse events (AEs), serious adverse events (SAEs) and abnormal laboratory test results. The RP2D definition will be based on integrated analysis of PK, tolerability or anti-tumor efficacy data. In Part B, the primary endpoints for determining anti-tumor efficacy is ORR according to RECIST 1.1 by Independent Review Committee (IRC).
Endpoint(s): Part A of the study (Phase I): •PK assessment includes concentrations of DZD9008 in plasma and/or urine of individual patient (secondary) •Preliminary assessment of anti-tumor efficacy includes the objective response rate (ORR), which includes the number of CR and PR based on RECIST v1.1, disease control rate (DCR), and duration of response (DoR) (secondary) •The effect of food on PK of DZD9008 (secondary) •To retrospectively assess anti-tumor activity of DZD9008 in patients with EGFR Exon20ins, Part B of the study (Phase II): •Safety and tolerability, including adverse events (AEs), serious adverseevents (SAEs) and abnormal laboratory test results (secondary) •PK assessment includes concentrations of DZD9008 in plasma of individual patient (secondary) •Additional anti-tumor efficacy endpoints include BOR, DOR, PFS and overall survival (OS) (secondary).

Source: https://euclinicaltrials.eu/ctis-public/view/2024-512127-36-00